EU clinical trial 2024-514355-16-01: PIrfenidone to prevent fibrOsis in ARDS. A RaNdomizEd controllEd tRial - PIONEER
Protocol code: GR-2019-12371063
Sponsor: Ospedale San Raffaele S.r.l. (Hospital/Clinic/Other health care facility). Phase: Therapeutic confirmatory (Phase III). Countries: Italy (authorised, recruitment pending).
Therapeutic area(s): Diseases [C] - Respiratory Tract Diseases [C08]
Gender: Female, Male. Age: 18-64 years, 65+ years. Enrolment: 100.
Status: Authorised, recruitment pending. Decision date: 2025-01-08. Results received: No. Last updated: 2025-01-08.

Condition(s): Acute Respiratory Distress Syndrome (ARDS)
Product: SODIO CLORURO 0,9% BAXTER Soluzione per infusione, Esbriet 267 mg film-coated tablets

Primary endpoint: The primary outcome of this clinical trial is to document an increase in the number of ventilator free days (VFD) at day 28 in the Pirfenidone group when compared to the placebo group.
Endpoint(s): Increase in ICU-free days at day 28, Increase in cumulative SOFA-free score at day 28, Reduction in hospital length of stay, Reduction in fibroproliferative changes on high-resolution CT performed at ICU discharge, according to specific interpretation guidelines, Mortality at ICU/hospital discharge, Better pulmonary function test (spirometry) at hospital discharge, Greater distance at the 6 minute walk test (at 6-12 months), Better Quality of life as measured by EQ-5D Health Questionnaire and SF-36 questionnaire, Right and left heart dysfunction as determined by echocardiography at ICU discharge, Adverse event rate, Use of rescue therapies for severe hypoxaemia

Source: https://euclinicaltrials.eu/ctis-public/view/2024-514355-16-01